EU clinical trial 2026-525179-26-00: A study to see how safe a new medicine (NNC6022-0004) is in healthy people and people living with obesity
Protocol code: NN6022-8271
Sponsor: Novo Nordisk A/S (Pharmaceutical company). Phase: Human Pharmacology (Phase I)- First administration to humans. Countries: Netherlands (ongoing, recruiting).
Therapeutic area(s): Not possible to specify
Gender: Female, Male. Age: 18-64 years. Enrolment: 128.
Status: Ongoing, recruiting. Start date (EU): 2026-07-03. Decision date: 2026-06-19. Results received: No. Last updated: 2026-07-15.
Decision dates by country: NL: 2026-07-15

Condition(s): Cardiometabolic

Source: https://euclinicaltrials.eu/ctis-public/view/2026-525179-26-00